EU clinical trial 2024-517779-19-00: A study to evaluate the safety, tolerability and distribution of TB0010 in head and neck squamous cell carcinoma
Protocol code: TB-H-01
Sponsor: Tenboron Oy (Pharmaceutical company). Phase: Human Pharmacology (Phase I)- First administration to humans. Countries: Finland (ended).
Therapeutic area(s): Diseases [C] - Neoplasms [C04]
Gender: Female, Male. Age: 18-64 years, 65+ years. Enrolment: 6.
Status: Ended. Start date (EU): 2024-01-05. End date (EU): 2025-12-01. Decision date: 2024-10-22. Results received: No. Last updated: 2025-10-02.

Condition(s): EGFR-Positive Head and Neck Squamous Cell Carcinoma

Source: https://euclinicaltrials.eu/ctis-public/view/2024-517779-19-00